EU clinical trial 2024-512496-12-00: A Phase 3, Multicenter, Open-Label Study to Evaluate the Long-term Safety, Tolerability, and Efficacy of TAK-279 in Subjects with Moderate-to-Severe Plaque Psoriasis
Protocol code: TAK-279-PsO-3003
Sponsor: Takeda Development Center Americas Inc. (Pharmaceutical company). Phase: Therapeutic confirmatory (Phase III). Countries: Czechia (ongoing, recruitment ended), Spain (ongoing, recruitment ended), Latvia (ongoing, recruitment ended), Poland (ongoing, recruitment ended), Italy (ongoing, recruitment ended), Hungary (ongoing, recruitment ended), Bulgaria (ongoing, recruitment ended), Germany (ongoing, recruitment ended), France (ongoing, recruitment ended).
Therapeutic area(s): Diseases [C] - Skin and Connective Tissue Diseases [C17]
Gender: Female, Male. Age: 18-64 years, 65+ years. Enrolment: 839.
Status: Ongoing, recruitment ended. Start date (EU): 2025-04-01. Decision date: 2025-01-16. Results received: No. Last updated: 2026-05-29.
Decision dates by country: HU: 2025-01-17, IT: 2025-01-17, DE: 2025-01-20, FR: 2025-07-28, ES: 2025-01-20, LV: 2025-01-16, BG: 2025-01-21, CZ: 2025-01-17, PL: 2025-01-21

Condition(s): Moderate to Severe Plaque Psoriasis
Product: ZASOCITINIB

Primary endpoint: Incidence of treatment-emergent adverses events (TEAEs), Incidence of serious adverse events (SAEs)
Endpoint(s): Over the duration of the study: ≥75% improvement in Psoriasis Area and Severity Index (PASI-75), Over the duration of the study: Static Physician Global Assessment (sPGA) of clear (0) or almost clear (1) with a ≥2-point decrease from baseline

Source: https://euclinicaltrials.eu/ctis-public/view/2024-512496-12-00